EU clinical trial 2025-522803-60-00: A Phase 2, open-label, randomized, dose optimization study evaluating the efficacy and safety of belantamab mafodotin administered in combination with cyclophosphamide, bortezomib, and dexamethasone in adult participants with newly diagnosed amyloid light chain amyloidosis (ALANIS)
Protocol code: 223963
Sponsor: Glaxosmithkline Research & Development Limited (Pharmaceutical company). Phase: Therapeutic exploratory (Phase II). Countries: Italy (authorised, recruitment pending), Greece (authorised, recruitment pending), Spain (not authorised).
Therapeutic area(s): Diseases [C] - Immune System Diseases [C20]
Gender: Female, Male. Age: 18-64 years. Enrolment: 17.
Decision date: 2026-07-21. Results received: No. Last updated: 2026-07-29.
Decision dates by country: IT: 2026-07-21, ES: 2026-07-22, GR: 2026-07-21

Condition(s): newly diagnosed amyloid light chain amyloidosis
Product: Dexamethason 8 mg GALEN® Tabletten, Endoxan®, VELCADE 3.5 mg powder for solution for injection, Bortezomib Hikma 3,5 mg Pulver zur Herstellung einer Injektionslösung, ENDOXAN 50 mg, comprimé enrobé, Fortecortin® 2 mg Tabletten

Primary endpoint: Overall Complete Hematologic Response (CHR) rate, defined as the proportion of participants who achieve a CHR, according to the consensus guidelines for AL amyloidosis, during or after study treatment initiation.
Endpoint(s): Incidence of adverse events (AEs), Serious adverse event (SAEs), and clinically significant changes in laboratory parameters., Incidence, severity, duration and resolution of ocular findings on ophthalmic examination (corneal examination findings and changes in Best corrected visual acuity [BCVA])., Organ response rate (OrRR) for kidney, heart, and/or liver defined as the proportion of baseline organ involved participants who achieve confirmed organ response in each corresponding organ., Duration of CHR defined as the time between the date of initial documentation of CHR to the date of first documented evidence of hematologic progressive disease (PD)., Derived PK parameter (e.g., Cmax, AUC) values for belantamab mafodotin and Cysteine maleimidocaproyl monomethyl auristatin F (cys-mcMMAF), as data permit., Anti-drug antibody (ADA) incidence and summary titers of ADAs against belantamab mafodotin.

Source: https://euclinicaltrials.eu/ctis-public/view/2025-522803-60-00